EU clinical trial 2023-506498-36-00: A Phase III, Randomized, Open-Label, Active controlled, Multicenter Study Evaluating the Efficacy and Safety of Crovalimab Versus Eculizumab in Patients with Paroxysmal Nocturnal Hemoglobinuria (PNH) not Previously Treated with Complement Inhibitors
Protocol code: BO42162
Sponsor: F. Hoffmann-La Roche AG (Pharmaceutical company). Phase: Therapeutic confirmatory (Phase III). Countries: Germany (ended), Poland (ended), Spain (ended), Sweden (ongoing, recruitment ended), France (ongoing, recruitment ended), Lithuania (ended), Portugal (ended), Romania (ongoing, recruitment ended), Netherlands (ended).
Therapeutic area(s): Diseases [C] - Hemic and Lymphatic Diseases [C15]
Gender: Female, Male. Age: 0-17 years, 18-64 years, 65+ years. Enrolment: 42.
Start date (EU): 2021-04-08. Decision date: 2024-06-28. Results received: No. Last updated: 2026-08-07.
Decision dates by country: SE: 2024-06-28, LT: 2024-07-23, NL: 2024-06-28, PT: 2024-07-08, RO: 2024-07-01, PL: 2024-07-23, ES: 2024-07-01, DE: 2024-06-28, FR: 2024-06-28

Condition(s): Paroxysmal Nocturnal Hemoglobinuria (PNH)
Product: ECULIZUMAB, Crovalimab, Crovalimab

Primary endpoint: 1. Proportion of patients who achieve transfusion avoidance, 2. Proportion of patients with hemolysis control, measured by LDH <=1.5×ULN
Endpoint(s): 1. Proportion of patients with breakthrough hemolysis, 2. Proportion of patients with stabilization of hemoglobin, 3. Mean change in fatigue, as assessed by the Functional Assessment of Chronic Illness Therapy (FACIT)-Fatigue, 4. Incidence and severity of adverse events, 5. Change from baseline in targeted vital signs, 6. Change from baseline in targeted clinical laboratory test results, 7. Incidence and severity of injection-site reactions, infusion-related reactions, hypersensitivity, and infections, 8. Incidence of adverse events leading to study drug discontinuation, 9. Incidence and severity of clinical manifestations of drug-target-drug complex formation in patients who switched to crovalimab treatment from eculizumab treatment, 10. Serum concentration of crovalimab and eculizumab, 11. Prevalence and incidence of anti-drug antibodies (ADAs) to crovalimab, 12. Change over time in pharmacodynamic biomarkers, 13. Change over time in free C5 concentration in crovalimab-treated patients, 14. Observed value and absolute change from baseline to week 25 in parameters reflecting hemolysis

Source: https://euclinicaltrials.eu/ctis-public/view/2023-506498-36-00